EU clinical trial 2025-522469-31-00: D. pteronyssinus and D. farinae allergen extracts. Study of the sensitivity and specificity of the prick test diagnostic preparation
Protocol code: M601-SSP-080
Sponsor: Inmunotek S.L. (Pharmaceutical company). Phase: Therapeutic confirmatory (Phase III). Countries: Spain (authorised, recruitment pending).
Therapeutic area(s): Diseases [C] - Immune System Diseases [C20]
Gender: Female, Male. Age: 0-17 years, 18-64 years, 65+ years. Enrolment: 70.
Status: Authorised, recruitment pending. Decision date: 2026-05-25. Results received: No. Last updated: 2026-05-25.

Condition(s): Allergy to Dermatophagoides pteronyssinus, Allergy to Dermatophagoides farinae
Product: Dermatophagoides farinae extract 100 HEP/mL solution for skin-prick test, Skin Prick Test Negative control, Skin Prick Test Positive control, Dermatophagoides pteronyssinus extract 100 HEP/mL solution for skin-prick test

Primary endpoint: Area (mm²) of wheals induced by different concentrations of the D. pteronyssinus allergen extract and the D. farinae allergen extract, as well as the areas of wheals induced by the positive control and negative control, using the prick test
Endpoint(s): - Safety parameters: • Overall rate, seriousness, and ratio of any adverse event (AE) by administration and by subject • Assessment of administration site reactions, systemic reactions and any medication administered for the treatment of adverse reaction (AR), - Allergen profiling (ALEX technique)

Source: https://euclinicaltrials.eu/ctis-public/view/2025-522469-31-00